EU clinical trial 2024-513625-23-00: A Study with ABBV-155 Alone and in Combination with Taxane Therapy in Adults with Relapsed and/or Refractory Solid Tumors
Protocol code: M16-573
Sponsor: AbbVie Deutschland GmbH & Co. KG (Pharmaceutical company). Phase: Human Pharmacology (Phase I)- First administration to humans. Countries: Netherlands (ended).
Therapeutic area(s): Diseases [C] - Neoplasms [C04]
Gender: Female, Male. Age: 18-64 years, 65+ years. Enrolment: 1.
Status: Ended. Start date (EU): 2021-03-15. End date (EU): 2025-09-12. Decision date: 2024-07-18. Results received: No. Last updated: 2025-09-15.

Condition(s): Patients with relapsed or refractory solid tumors, including: Small cell lung cancer (SCLC); Non-small cell cancer (NSCLC); Breast cancer

Source: https://euclinicaltrials.eu/ctis-public/view/2024-513625-23-00